EU clinical trial 2024-517549-15-00: Nitrous Oxide in Resistant Depression in Elderly Subjects: A Randomized, Double-blind, Comparator Trial
Protocol code: PROTO-BRAIN
Sponsor: Centre Hospitalier Regional Universitaire De Tours (Hospital/Clinic/Other health care facility). Phase: Therapeutic confirmatory (Phase III). Countries: France (ended).
Therapeutic area(s): Psychiatry and Psychology [F] - Mental Disorders [F03]
Gender: Female, Male. Age: 18-64 years, 65+ years. Enrolment: 60.
Status: Ended. Start date (EU): 2021-11-16. End date (EU): 2024-12-19. Decision date: 2024-11-12. Results received: Yes. Last updated: 2024-11-12.

Condition(s): Resistant Depression in the Elderly Subject
Product: Medical Air, KALINOX 50%/50%, gaz médicinal comprimé

Primary endpoint: MADRS Depression Severity Scale collected collected at baseline, 2 hours, 24 hours, Week 1 and Week 2 in MEOPA vs comparator group
Endpoint(s): Brain Pulsatility Indices as measured by IPT Ultrasound Imaging, Brain volume and white matter lesion indices measured by MRI, indicators of brain atrophy and lesion load; Brain perfusion indices measured by MRI-ASL; Pulsatilité́ and Brain Connectivity indices as measured by MRI in BOLD signal, A series of scales complementary to the MADRS for the evolution of depressive symptoms (Hamilton 17-items, CGI - Clinical Global Impression, QIDS-SR - Quick Inventory of Depressive Symptomatology Self Report), A series of scales for the evaluation of possible adverse effects (SSI - Scale for Suicidal Ideation, YMRS - Young Mania Rating Scale, CADSS - Clinician Administered Dissociative States Scale, BPRS - Brief Psychiatric Rating Scale)

Source: https://euclinicaltrials.eu/ctis-public/view/2024-517549-15-00